EU clinical trial 2024-517478-68-01: The Finnish National Study to Facilitate Patient Access to Targeted Anti-cancer Drugs to determine the Efficacy in Treatment of Advanced Cancers with a Known Molecular Profile
Protocol code: FINPROVE
Sponsor: HUS-Yhtymae (Hospital/Clinic/Other health care facility). Phase: Therapeutic exploratory (Phase II). Countries: Finland (ongoing, recruiting).
Therapeutic area(s): Diseases [C] - Neoplasms [C04]
Gender: Female, Male. Age: 18-64 years, 65+ years. Enrolment: 250.
Status: Ongoing, recruiting. Start date (EU): 2024-11-06. Decision date: 2024-11-06. Results received: No. Last updated: 2026-06-18.

Condition(s): Advanced Cancer
Product: Verzenios 50 mg film-coated tablets, Tecentriq 840 mg concentrate for solution for infusion, Alecensa 150 mg hard capsules, Erivedge 150 mg hard capsules, Iclusig 15 mg film-coated tablets, Phesgo 1200 mg/600 mg solution for injection, Scemblix 40 mg film-coated tablets, Mekinist 2 mg film-coated tablets, Tafinlar 75 mg hard capsules, Zelboraf 240 mg film-coated tablets, Stivarga 40 mg film-coated tablets, Cotellic 20 mg film-coated tablets, Erleada 60 mg film-coated tablets, Mekinist 0.5 mg film-coated tablets, Lynparza 150 mg film-coated tablets, Pemazyre 4.5 mg tablets, TEPMETKO 225 mg film-coated tablets, Phesgo 600 mg/600 mg solution for injection, Rozlytrek 200 mg hard capsules

Primary endpoint: Disease control rate at 16 weeks after treatment initiation (defined as patients by CR, PR, SD)
Endpoint(s): Duration of treatment on study (time on drug), Treatment-related grade ≥3 and serious adverse events, Best overall response (defined as patients by CR, PR, SD), Progression free survival, Overall survival

Source: https://euclinicaltrials.eu/ctis-public/view/2024-517478-68-01